EU clinical trial 2025-523005-15-00: A Phase 1b/2 Study to Evaluate the Safety and Efficacy of MK‑1045 Monotherapy or in Combination with Other Anticancer Agents in Participants with Non-Hodgkin Lymphoma
Protocol code: MK-1045-008
Sponsor: Merck Sharp & Dohme LLC (Pharmaceutical company). Phase: Phase I and Phase II (Integrated)- Other. Countries: Poland (ongoing, recruiting), Italy (authorised, recruiting), France (authorised, recruitment pending), Germany (authorised, recruitment pending), Spain (ongoing, recruiting).
Therapeutic area(s): Diseases [C] - Neoplasms [C04]
Gender: Female, Male. Age: 18-64 years, 65+ years. Enrolment: 73.
Start date (EU): 2026-06-15. Decision date: 2026-05-28. Results received: No. Last updated: 2026-07-20.
Decision dates by country: IT: 2026-05-28, ES: 2026-06-01, PL: 2026-05-29, DE: 2026-05-29, FR: 2026-05-28

Condition(s): Non-Hodgkin Lymphoma
Product: TOCILIZUMAB, MK-1045

Primary endpoint: Number of Participants Who Experience an Adverse Event (AE), Number of Participants Who Discontinue Study Treatment Due to an AE, Arms 2 and 3: Number of Participants Who Experience Dose Limiting Toxicity (DLT), Arms 1 and 4: Objective Response Rate (ORR) per Lugano Response Criteria as assessed by Blinded Independent Central Review (BICR), Arm 2: ORR per Lugano Response Criteria as assessed by Investigator
Endpoint(s): Arms 1 and 4: Duration of Response (DOR) per Lugano Response Criteria as assessed by BICR, Arms 2 and 3: DOR per Lugano Response Criteria as assessed by Investigator, Area Under the Concentration-time Curve Measured at Steady State (AUCss) of MK-1045, Trough Concentration (Ctrough) of MK-1045, Maximum Serum Concentration (Cmax) of MK-1045, Arms 1, 2, and 4: Time to Maximum Serum Concentration (Tmax) of MK-1045, Arm 3: Absolute Bioavailability Expressed as a Percentage (F%) of MK-1045, Arm 3: ORR per Lugano Response Criteria as assessed by Investigator

Source: https://euclinicaltrials.eu/ctis-public/view/2025-523005-15-00